EU clinical trial 2023-503659-88-00: J1I-MC-GZBM: A Randomized, Double-Blind, Phase 3 Study to Investigate the Efficacy and Safety of LY3437943 Once Weekly Compared to Placebo in Participants with Severe Obesity and Established Cardiovascular Disease (TRIUMPH-3)
Protocol code: J1I-MC-GZBM
Sponsor: Eli Lilly & Co. (Pharmaceutical company). Phase: Therapeutic confirmatory (Phase III). Countries: Slovakia (ended), Hungary (ended), Spain (ended), Poland (ended).
Therapeutic area(s): Diseases [C] - Nutritional and Metabolic Diseases [C18]
Gender: Female, Male. Age: 18-64 years, 65+ years. Enrolment: 389.
Status: Ended. Start date (EU): 2023-09-05. End date (EU): 2026-04-21. End date: 2026-05-14. Decision date: 2023-08-22. Results received: No. Last updated: 2026-06-25.
Decision dates by country: HU: 2023-08-25, PL: 2023-08-28, SK: 2023-08-22, ES: 2023-08-24

Condition(s): Cardiovascular Disease, Obesity
Product: Retatrutide, Retatrutide, Retatrutide, Placebo Injection, Retatrutide, Retatrutide

Primary endpoint: Percent Change from Baseline in Body Weight

Source: https://euclinicaltrials.eu/ctis-public/view/2023-503659-88-00